EU clinical trial 2024-517131-52-00: A Phase 3 Randomized, Open-Label, Multicenter Study of Sonrotoclax Plus Anti-CD20 Antibody Therapies Versus Venetoclax Plus Rituximab in Patients With Relapsed/Refractory Chronic Lymphocytic Leukemia/Small Lymphocytic Lymphoma
Protocol code: BGB-11417-303CLL-RR1
Sponsor: BeOne Medicines AG (Pharmaceutical company). Phase: Therapeutic confirmatory (Phase III). Countries: France (ongoing, recruiting), Sweden (ongoing, recruiting), Czechia (ongoing, recruiting), Austria (ongoing, recruiting), Belgium (ongoing, recruiting), Germany (ongoing, recruiting), Denmark (ongoing, recruiting), Spain (ongoing, recruiting), Netherlands (ongoing, recruiting), Italy (ongoing, recruiting), Ireland (ongoing, recruiting), Poland (ongoing, recruiting).
Therapeutic area(s): Diseases [C] - Neoplasms [C04]
Gender: Female, Male. Age: 18-64 years, 65+ years. Enrolment: 285.
Status: Ongoing, recruiting. Start date (EU): 2025-11-03. Decision date: 2025-09-26. Results received: No. Last updated: 2026-04-14.
Decision dates by country: AT: 2025-09-29, BE: 2025-11-10, DK: 2025-09-26, FR: 2025-09-30, DE: 2025-11-12, IE: 2025-11-07, IT: 2025-11-11, ES: 2025-09-29, SE: 2025-09-29, NL: 2025-11-10, PL: 2025-11-13, CZ: 2025-11-11

Condition(s): Relapsed/Refractory Chronic Lymphocytic Leukemia/Small Lymphocytic Lymphoma
Product: Venclyxto 10 mg film-coated tablets, Venclyxto 100 mg film-coated tablets, BGB-11417, MabThera 100 mg concentrate for solution for infusion, BGB-11417, BGB-11417, Gazyvaro 1,000 mg concentrate for solution for infusion., BGB-11417, MabThera 500 mg concentrate for solution for infusion, Venclyxto 50 mg film-coated tablets

Primary endpoint: PFS, defined as the time from the date of randomization to the date of disease progression as determined by the blinded independent review committee (BIRC) or death, whichever occurs first.
Endpoint(s): PFS, defined as the time from the date of randomization to the date of disease progression as determined by the BIRC or death, whichever occurs first., • Undetectable minimal residual disease at < 10-4 sensitivity (uMRD4) rate in peripheral blood at C14D1 Visit based on next-generation sequencing (NGS [clonoSEQ]). • Complete response rate (CRR), defined as the proportion of patients that achieve a best response of CR or CRi (CR/CRi), as determined by the BIRC. • OS, defined as the time from the date of randomization to the date of death., • PFS per investigator assessment. • CRR per the BIRC and investigator assessment. • OS. • Rate of uMRD4 (C8D1, C11D1, C14D1, and Posttreatment follow-up [PTFU]1) based on NGS (clonoSEQ)., • PFS per BIRC and investigator assessment. • CRR per BIRC and investigator assessment. • OS. • Rate of uMRD4 (C8D1, C11D1, C14D1, and PTFU1) based on NGS (clonoSEQ)., • Rate of uMRD4 (C8D1, C11D1 and PTFU1) based on NGS (clonoSEQ). • CRR per investigator assessment. • PFS per investigator assessment., • PFS per investigator assessment. • CRR per investigator assessment. • OS. • Rate of uMRD4 (C8D1, C11D1, C14D1, and PTFU1) based on NGS (clonoSEQ)., • ORR, defined as the proportion of patients that achieve a best response of partial response (PR) or better, as determined by the BIRC and investigator assessment. • DOR, defined as the time from the date that response criteria were first met to the date of first documentation of disease progression or death, whichever occurred first per the BIRC and investigator assessment., • TTR, defined as the time from the date of randomization to the date response criteria were first met, per the BIRC and investigator assessment. • TTNT, defined as the time from the date of randomization to the date of next anti-CLL/SLL treatment. (The BIRC assessments are applicable for Arms A, B, and D only.), Rate of uMRD4 in peripheral blood at C8D1, C11D1, C14D1, C20D1, PTFU1, and subsequent follow-up timepoints, Global health status/QoL and physical functioning as measured by EORTC-QLQ-C30 and Symptom burden due to disease or treatment (symptom burden) and physical condition/fatigue (fatigue) as measured by EORTC QLQ-CLL17., Safety (adverse events, serious adverse events, changes from baseline in clinical laboratory tests, physical examinations, and vital signs).

Source: https://euclinicaltrials.eu/ctis-public/view/2024-517131-52-00